EU clinical trial 2024-517378-22-00: Immune checkpoint inhibitors and Carbon iON radiotherapy In solid Cancers with stable disease (ICONIC)
Protocol code: CNAO 44 2021C
Sponsor: Fondazione Centro Nazionale Di Adroterapia Oncologica (Patient organisation/association). Phase: Therapeutic exploratory (Phase II). Countries: Italy (authorised, recruitment pending).
Therapeutic area(s): Diseases [C] - Neoplasms [C04]
Gender: Female, Male. Age: 18-64 years, 65+ years. Enrolment: 27.
Status: Authorised, recruitment pending. Decision date: 2024-11-26. Results received: No. Last updated: 2024-11-26.

Condition(s): Unresectable or metastatic melanoma, Locally advanced or metastatic urothelial carcinoma, Locally advanced or metastatic non-small cell lung cancer (NSCLC), Untreated recurrent/metastatic head & neck sqamous cell carcinoma (HNSCC)
Product: PEMBROLIZUMAB, ATEZOLIZUMAB, NIVOLUMAB, CEMIPLIMAB

Primary endpoint: Objective response rate (ORR) according to RECIST, assessed at least 8 weeks after CIRT, Toxicity according to CTCAE version 5.0
Endpoint(s): progression-free survival (PFS), overall survival (OS), objective response rate (ORR) according to irRECIST, percentage of patients with disease progression as best response, objective response of the metastatic lesion treated with CIRT, disease control rate (DCR) according to RECIST, defined as ORR+SD

Source: https://euclinicaltrials.eu/ctis-public/view/2024-517378-22-00